EU clinical trial 2025-521327-67-00: A Phase II, Randomized, Multicenter, Open-Label Study Evaluating the Efficacy and Safety of the Combination of Inavolisib Plus Enzalutamide Versus Physician's Choice of ARPI or Docetaxel in Patients With Metastatic Castration-Resistant Prostate Cancer
Protocol code: CO45813
Sponsor: F. Hoffmann-La Roche AG (Pharmaceutical company). Phase: Therapeutic exploratory (Phase II). Countries: Germany (ongoing, recruiting), France (ongoing, recruiting), Italy (ongoing, recruiting), Spain (ongoing, recruiting).
Therapeutic area(s): Diseases [C] - Neoplasms [C04]; Not possible to specify
Gender: Male. Age: 18-64 years, 65+ years. Enrolment: 32.
Status: Ongoing, recruiting. Start date (EU): 2026-04-13. Decision date: 2026-03-06. Results received: No. Last updated: 2026-08-06.
Decision dates by country: IT: 2026-03-06, ES: 2026-03-10, DE: 2026-03-09, FR: 2026-03-09

Condition(s): Metastatic Castration-Resistant Prostate Cancer
Product: ABIRATERONE, DOCETAXEL, ENZALUTAMIDE, INAVOLISIB, ENZALUTAMIDE, INAVOLISIB

Primary endpoint: Radiographic Progression-Free Survival (rPFS)
Endpoint(s): Confirmed Composite Response Rate (RR), Confirmed prostate-specific antigen 90 (PSA90), Confirmed prostate-specific antigen 50 (PSA50), Objective Response Rate (ORR), Duration of Response (DOR), Overall Survival (OS), Incidence and severity of adverse events, with severity determined according to the National Cancer Institute Common Terminology Criteria for Adverse Events, version 5.0 (NCI CTCAE v5.0), Change from baseline in selected vital signs, Change from baseline in selected clinical laboratory test results

Source: https://euclinicaltrials.eu/ctis-public/view/2025-521327-67-00